EU clinical trial 2023-508343-48-00: Tisagenlecleucel versus standard of care in adult patients with relapsed or refractory aggressive B-cell non-Hodgkin lymphoma: A randomized, open label, phase III trial (BELINDA)
Protocol code: CCTL019H2301
Sponsor: Novartis Pharma AG (Pharmaceutical company). Phase: Therapeutic confirmatory (Phase III). Countries: Netherlands (ended), Spain (ended), Norway (ended), Italy (ended), Germany (ended), France (ended), Austria (ended).
Therapeutic area(s): Diseases [C] - Neoplasms [C04]
Gender: Female, Male. Age: 18-64 years, 65+ years. Enrolment: 128.
Status: Ended. Start date (EU): 2019-01-25. End date (EU): 2026-02-02. End date: 2026-02-03. Decision date: 2024-05-21. Results received: No. Last updated: 2026-01-22.
Decision dates by country: NO: 2024-05-22, NL: 2024-05-21, AT: 2024-05-28, IT: 2024-06-03, ES: 2024-05-24, DE: 2024-05-24, FR: 2024-06-17

Condition(s): Adult patients with relapsed or refractory aggressive B-cell non-Hodgkin lymphoma
Product: DEXAMETHASONE, FLUDARABINE, CISPLATIN, OXALIPLATIN, CARBOPLATIN, LENALIDOMIDE, RITUXIMAB, TOCILIZUMAB, CYCLOPHOSPHAMIDE, BENDAMUSTINE, TISAGENLECLEUCEL, IFOSFAMIDE, MELPHALAN, CYTARABINE, CARMUSTINE, IBRUTINIB, ETOPOSIDE, GEMCITABINE

Primary endpoint: EFS, defined as time from date of randomization to the date of first documented disease progression or stable disease at or after the week 12 (±1 week) assessment, as assessed by blinded independent review committee (BIRC) per Lugano criteria, or death at any time
Endpoint(s): EFS as assessed by local investigator, OS: defined as the time from randomization to date of death, ORR: overall response rate as per the Lugano criteria Duration of response: time from the date of first documented response of CR or PR to the date of first documented progression (SD or PD at or after the week 12 (±1w) assessment will be considered progression) or death due to aggressive B-cell NHL TTR: time from the date of randomization to the date of a patient first achieved a response of CR or PR on or after the Week 12 assessment, Type, frequency and severity of serious and non-serious adverse events and laboratory abnormalities and discontinuations due to adverse events, Time to definitive deterioration in SF-36v2, FACT-Lym, and EQ-VAS, EFS, OS and AE, Summary of qPCR detected tisagenlecleucel transgene concentrations in peripheral blood and bone marrow (and other tissue, if available), and cellular kinetic parameters from peripheral blood profile samples by time point and clinical response status, Summary of pre-existing and treatment induced immunogenicity (cellular and humoral) of tisagenlecleucel Levels of pre-existing and treatment induced immunogenicity. Cellular kinetic parameters, concentration-time profile by immunogenicity category (positive/negative), and efficacy (Month 3 response), RCL by VSV-qPCR

Source: https://euclinicaltrials.eu/ctis-public/view/2023-508343-48-00